EU clinical trial 2024-518769-80-00: HAMLETT; Handling Antipsychotic Medication: Long-term Evaluation of Targeted Treatment. A pragmatic single blind RCT of continuation versus discontinuation/ dose reduction of antipsychotic medication in patients remitted after a first episode of psychosis
Protocol code: NL6220204217
Sponsor: Universitair Medisch Centrum Groningen (Hospital/Clinic/Other health care facility). Phase: Therapeutic use (Phase IV). Countries: Netherlands (ongoing, recruitment ended).
Therapeutic area(s): Psychiatry and Psychology [F] - Mental Disorders [F03]
Gender: Female, Male. Age: 0-17 years, 18-64 years. Enrolment: 444.
Status: Ongoing, recruitment ended. Start date (EU): 2024-11-25. Decision date: 2024-11-25. Results received: No. Last updated: 2024-11-25.

Condition(s): HAMLETT compares regular treatment guidelines for patients in remission after a first episode of psychosis, namely continuation with antipsychotic medication for at least one year, with early dose reduction/discontinuation.
Product: HALOPERIDOL, CLOZAPINE, TIAPRIDE, SERTINDOLE, PALIPERIDONE, OLANZAPINE, SULPIRIDE, ARIPIPRAZOLE, LURASIDONE, RISPERIDONE, AMISULPRIDE, CHLORPROMAZINE, PIMOZIDE, QUETIAPINE

Primary endpoint: Primary outcome measure is based on what patients and their relatives deemed most important as assessed in a survey conducted by Anoiksis (a Dutch patient organisation). This was a long term social recovery and is best quantified with the World Health Organization's Disability Assessment Schedule (WHODAS-II)
Endpoint(s): econdary outcome measures are: side effects of medication use, personal wellbeing, quality of life, symptom severity, physical health (body mass index, somatic comorbidity including metabolic syndrome), aggression and self-harm, cognitive functioning, movement disorders, number and duration of psychotic relapses, number and duration of psychiatric treatments, cigarette alcohol and drug abuse. Ecological momentary assessments (EMA) as measure of social functioning and well-being in daily life.

Source: https://euclinicaltrials.eu/ctis-public/view/2024-518769-80-00